EU clinical trial 2023-509278-41-00: Early Stage Follicular LymphOma and RadioTherapy PLUS anti-CD20 Antibody
Protocol code: FORTplus
Sponsor: Universitaetsklinikum Heidelberg AöR (Hospital/Clinic/Other health care facility). Phase: Therapeutic confirmatory (Phase III). Countries: Germany (ongoing, recruiting).
Therapeutic area(s): Diseases [C] - Hemic and Lymphatic Diseases [C15]
Gender: Female, Male. Age: 18-64 years, 65+ years. Enrolment: 130.
Status: Ongoing, recruiting. Start date (EU): 2022-07-04. Decision date: 2024-01-25. Results received: No. Last updated: 2026-05-08.

Condition(s): Early Stage Follicular LymphOma
Product: Gazyvaro 1,000 mg concentrate for solution for infusion., MabThera 500 mg concentrate for solution for infusion

Primary endpoint: Morphologic complete response (CR) in week 18 in patients with remaining macroscopic PET positive lymphoma after initial diagnostic biopsy judged by CT (centrally reviewed)
Endpoint(s): Morphologic CR, PR, SD, PD in week 7 and month 6 in patients with initially remaining lymphoma judged by CT/MRI, Metabolic CR in week 18 in patients with initially remaining lymphoma judged by FDGPET/ CT (centrally reviewed), Progression-free survival (PFS) of each treatment arm (2 years after individual treatment start), PFS of patients in stage I0 after diagnostic surgery (no remaining lymphoma) treated as the experimental arm (2 years after individual treatment start), Toxicity (NCI-CTC criteria, version 5) of all patients, Relapse rate and pattern of recurrence of each treatment arm at all follow-up visits., Overall survival (OS) of each treatment arm (2 years), Quality of life according EORTC QLQ C30 and FACT-Lym questionnaires at inclusion and in week 18, month 12, and 24 (each treatment arm)

Source: https://euclinicaltrials.eu/ctis-public/view/2023-509278-41-00